EU clinical trial 2024-517865-17-01: Chronotherapy in Inflammatory Arthritis (ChronIA trial): a randomized controlled trial comparing the effectiveness of morning and evening dosing of tofacitinib extended-release
Protocol code: ChronIA001
Sponsor: Erasmus Universitair Medisch Centrum Rotterdam (Erasmus MC) (Hospital/Clinic/Other health care facility). Phase: Therapeutic use (Phase IV). Countries: Netherlands (ongoing, recruiting).
Therapeutic area(s): Diseases [C] - Immune System Diseases [C20]
Gender: Female, Male. Age: 18-64 years, 65+ years. Enrolment: 84.
Status: Ongoing, recruiting. Start date (EU): 2024-09-30. Decision date: 2024-09-30. Results received: No. Last updated: 2024-09-30.

Condition(s): Rheumatoid arthritis or psoriatic arthritis according to respectively 2010 criteria or CASPAR criteria
Product: XELJANZ 11 mg prolonged-release tablets

Primary endpoint: The difference in self-reported disease activity, measured with the Routine Assessment of Patient Index Data 3 (RAPID-3), between morning and evening dosing of tofacitinib XR after 3 months of treatment.
Endpoint(s): Secondary endpoints are: (self-reported) disease activity (states); morning stiffness; general health; fatigue; pain; sleep; functional ability; quality of life; worker productivity; treatment satisfaction; and compliance., In addition, we will investigate whether the expression of circadian clock genes and microbiota composition change over time and whether these changes correlate with treatment response.

Source: https://euclinicaltrials.eu/ctis-public/view/2024-517865-17-01